EU clinical trial 2024-520200-26-00: LUSPARA - A basket phase II clinical trial evaluating Luspatercept in patients affected with rare inherited anemias
Protocol code: LUSPARA
Sponsor: Eurobloodnet Association (Patient organisation/association). Phase: Therapeutic exploratory (Phase II). Countries: Italy (authorised, recruitment pending), France (ongoing, recruiting).
Therapeutic area(s): Diseases [C] - Hemic and Lymphatic Diseases [C15]
Gender: Female, Male. Age: 18-64 years, 65+ years. Enrolment: 45.
Start date (EU): 2026-02-13. Decision date: 2025-10-24. Results received: No. Last updated: 2026-01-16.
Decision dates by country: IT: 2025-10-24, FR: 2025-10-27

Condition(s): Inherited anemias
Product: Reblozyl 25 mg powder for solution for injection, Reblozyl 75 mg powder for solution for injection

Primary endpoint: the proportion of patients who achieve an erythroid response, defined as a reduction in the transfusion burden of at least 33% from baseline (the 12-week period before the first dose of luspatercept) during 12 weeks plus a reduction of at least 2 red cell units over this 12-week interval., The proportion of patients with a mean hemoglobin concentration increase of 1.0 g/dL or higher from baseline over a continuous 12-week interval in the absence of red blood cell transfusions
Endpoint(s): Proportion of patients with a reduction in the transfusion burden of at least 33% from baseline during weeks 13 through 24 plus a reduction of at least 2 red-cell units over this 12-week interval,, Proportion of patients with a reduction in the transfusion burden of at least 50% from baseline during weeks 13 through 24 plus a reduction of at least 2 red-cell units over this 12-week interval,, Proportion of patients with a reduction in the transfusion burden of at least 33% from baseline during weeks 37 through 48 plus a reduction of at least 2 red-cell units over this 12-week interval, Proportion of patients with a reduction in the transfusion burden of at least 50% from baseline during weeks 37 through 48 plus a reduction of at least 2 red-cell units over this 12-week interval, Mean change from baseline in the transfusion burden during weeks 13 through 24 and during weeks 37 through 48

Source: https://euclinicaltrials.eu/ctis-public/view/2024-520200-26-00